EU clinical trial 2023-505335-12-00: Open label, four-period, two-sequence, fully replicated, randomized, single dose pivotal study for the assessment of bioequivalence between Furosemide 500 mg tablets (Test) and Lasix 500 mg tablets (Reference) in healthy male volunteers under fasting conditions
Protocol code: FMS-BESD-05-RPM/23
Sponsor: Ratiopharm GmbH (Pharmaceutical company). Phase: Human Pharmacology (Phase I)- Bioequivalence Study. Countries: Romania (not authorised).
Therapeutic area(s): Diseases [C] - Female Urogenital Diseases and Pregnancy Complications [C13]; Diseases [C] - Male Urogenital Diseases [C12]
Gender: Male. Age: 18-64 years. Enrolment: 50.
Status: Not authorised. Decision date: 2023-10-16. Results received: No. Last updated: 2023-10-16.

Condition(s): Not applicable. The study will be conducted on healthy volunteers.

Source: https://euclinicaltrials.eu/ctis-public/view/2023-505335-12-00